EU clinical trial 2026-526397-17-00: An open label, randomized, single-dose, two-treatment, two-sequence, two-period, cross-over pilot comparative bioavailability study comparing Empagliflozin and Metformin f.c. tabs (12.5+1000) mg, VIANEX S.A., Greece versus Synjardy 12.5 mg/1,000 mg film-coated tablets, Boehringer Ingelheim International GmbH, Germany, in healthy male and female volunteers under fasting conditions.
Protocol code: CPA 578-26
Sponsor: Vianex S.A. (Pharmaceutical company). Phase: Human Pharmacology (Phase I)- Bioequivalence Study. Countries: Czechia (authorised, recruitment pending).
Therapeutic area(s): Diseases [C] - Hormonal diseases [C19]
Gender: Female, Male. Age: 18-64 years. Enrolment: 18.
Status: Authorised, recruitment pending. Decision date: 2026-08-05. Results received: No. Last updated: 2026-08-05.

Condition(s): treatment of diabetes

Source: https://euclinicaltrials.eu/ctis-public/view/2026-526397-17-00